EU clinical trial 2023-505816-39-00: A Randomized, Open-Label, Phase II Study of Immune Checkpoint Inhibitor Combinations With Axitinib in Patients with Previously Untreated Locally Advanced Unresectable or Metastatic Renal Cell Carcinoma
Protocol code: BO43936
Sponsor: F. Hoffmann-La Roche AG (Pharmaceutical company). Phase: Therapeutic exploratory (Phase II). Countries: Spain (ended), Poland (ongoing, recruitment ended), Germany (ongoing, recruitment ended), France (ended).
Therapeutic area(s): Diseases [C] - Neoplasms [C04]
Gender: Female, Male. Age: 18-64 years, 65+ years. Enrolment: 113.
Start date (EU): 2023-04-04. Decision date: 2024-04-11. Results received: No. Last updated: 2026-04-22.
Decision dates by country: FR: 2024-05-23, PL: 2024-04-29, ES: 2024-04-11, DE: 2024-04-11

Condition(s): Untreated Locally Advanced Unresectable or Metastatic Renal Cell Carcinoma

Primary endpoint: 1. Incidence and severity of adverse events, with severity graded according to National Cancer Institute Common Terminology Criteria for Adverse Events (NCI CTCAE) v5.0. with the exception of cytokine release syndrome (CRS) event severity which will be determined according to the American Society for Transplantation and Cellular Therapy (ASTCT) CRS Consensus Grading scale

Source: https://euclinicaltrials.eu/ctis-public/view/2023-505816-39-00